EU clinical trial 2023-510041-16-00: Glaucoma Intensity Treatment Study – Intensive non-invasive glaucoma treatment vs conventional stepwise treatment – a prospective, randomized phase IV study of disease progression in glaucoma
Protocol code: GITS
Sponsor: Region Vaesterbotten (Hospital/Clinic/Other health care facility). Phase: Therapeutic use (Phase IV). Countries: Sweden (ongoing, recruitment ended).
Therapeutic area(s): Phenomena and Processes [G] - Ocular Physiological Phenomena [G14]
Gender: Female, Male. Age: 18-64 years, 65+ years. Enrolment: 240.
Status: Ongoing, recruitment ended. Start date (EU): 2013-04-22. Decision date: 2024-05-16. Results received: No. Last updated: 2024-05-16.

Condition(s): Glaucoma, open-angle and PEX glaucoma
Product: BRIMONIDINE, PILOCARPINE, BRINZOLAMIDE, TIMOLOL, LATANOPROST, BRINZOLAMIDE, COMBINATIONS, TRAVOPROST, BETAXOLOL, BIMATOPROST, DORZOLAMIDE, TIMOLOL, COMBINATIONS, TAFLUPROST

Primary endpoint: Rate of progression, the aim of the study is to compare and follow-up the patients on traditional clinical treatment with those receiving more intensive treatment, and measure the rate of progression as long as possible.
Endpoint(s): Quality of life, Compliance and adherence

Source: https://euclinicaltrials.eu/ctis-public/view/2023-510041-16-00